EU clinical trial 2023-505854-16-00: Klinefelter syndrome – the effect of Testosterone treatment In PubertY A randomized, double-blind placebo-controlled intervention study ‘The TiPY study’
Sponsor: Rigshospitalet (Hospital/Clinic/Other health care facility). Phase: Therapeutic use (Phase IV). Countries: Denmark (ongoing, recruiting).
Therapeutic area(s): Diseases [C] - Hormonal diseases [C19]; Diseases [C] - Male Urogenital Diseases [C12]
Gender: Male. Age: 0-17 years. Enrolment: 32.
Status: Ongoing, recruiting. Start date (EU): 2025-04-01. Decision date: 2023-09-20. Results received: No. Last updated: 2026-05-29.

Condition(s): 47,XXY (Klinefelter syndrome)
Product: The placebo consists of a gel for transdermal application. It is manufacured by Besins Healthcare in France. It is provided in bottles with a pump. The bottles are identical to the bottles with Androgel 1%., AndroGel 1%

Primary endpoint: Change in body composition as evaluated by whole body dual energy x-ray absorptiometry (DEXA) scan and measurement of body fat percentage, ratio between android and gynoid fat percentage and muscle mass.
Endpoint(s): Pubertal development (Tanner stageing), voice frequency and measurement of reproductive hormones in serum., Height, weight, sitting-height, head circumference, arm span, measurement of IGF1, IGF1BP3 in serum, and evaluation of bone age (xray), serum cholesterol (total, HDL, LDL), triglyceride, free fatty acids, glycerol, adiponectin, leptin, glucose, insulin, HbA1C, IL-6, TNF-α, IL-1RA, hsCRP/CRP, neuropsychological assessment before and after 2 year treatment, Bone health evaluated by whole body DEXA and Bone Health Index (BHI), and measurement of bone turnover markers (25-OH-vitamin D, calcium, phosphate, magnesium, PTH, alkaline phosphatase (liver and bone), osteocalcin, PINP (procollagen type I N-terminal propetide), CTX (carboxy terminal telopeptide of collagen type I), RANKL (receptor activator of nuclear factor kappa-B ligand), OPG (osteoprogeterin), Klotho, sclerostin and TRACP 5b (tartrate-resistant acid phosphatase 5b), grip-strength, Electrocardiogram with evaluation of QTc, Semen quality (if the boy is able and willing to deliver a semen sample)

Source: https://euclinicaltrials.eu/ctis-public/view/2023-505854-16-00